EU clinical trial 2024-512848-30-00: C4391025_AN INTERVENTIONAL, OPEN-LABEL, RANDOMIZED, MULTICENTER, PHASE 2 STUDY OF PF-07220060 PLUS LETROZOLE COMPARED TO LETROZOLE ALONE IN POSTMENOPAUSAL WOMEN 18 YEARS OR OLDER WITH HORMONE RECEPTOR-POSITIVE, HER2-NEGATIVE BREAST CANCER IN THE NEOADJUVANT SETTING
Protocol code: C4391025
Sponsor: Pfizer Inc. (Pharmaceutical company). Phase: Therapeutic exploratory (Phase II). Countries: Italy (ended), Spain (ended), France (ended), Slovakia (ended), Germany (ended), Sweden (ended), Poland (ended), Belgium (ended).
Therapeutic area(s): Diseases [C] - Neoplasms [C04]
Gender: Female. Age: 18-64 years, 65+ years. Enrolment: 76.
Status: Ended. Start date (EU): 2024-11-12. End date (EU): 2025-07-10. End date: 2025-07-11. Decision date: 2024-10-17. Results received: Yes. Last updated: 2025-08-26.
Decision dates by country: DE: 2024-10-21, PL: 2024-10-22, SK: 2024-10-18, BE: 2024-10-17, ES: 2024-10-18, SE: 2024-10-17, IT: 2024-10-18, FR: 2024-10-22

Condition(s): HORMONE RECEPTOR-POSITIVE, HER2-NEGATIVE BREAST CANCER
Product: Letrozole SanoSwiss 2,5 mg plėvele dengtos tabletės

Primary endpoint: CCCA (Ki-67 ≤2.7%) rates at Day 14 (centrally assessed biopsy).
Endpoint(s): Incidence of all AEs, SAEs, and AEs leading to study drug discontinuation., ctDNA measurements at baseline and Day 14., Ctrough and peri-biopsy plasma concentrations of PF-07220060., Ki-67 staining.

Source: https://euclinicaltrials.eu/ctis-public/view/2024-512848-30-00